EU clinical trial 2025-522311-41-00: A study in healthy men to test how BI 1584862 is processed in the body
Protocol code: 1484-0017
Sponsor: Boehringer Ingelheim International GmbH (Pharmaceutical company). Phase: Human Pharmacology (Phase I)- Other. Countries: Netherlands (ended).
Therapeutic area(s): Not possible to specify
Gender: Male. Age: 18-64 years. Enrolment: 8.
Status: Ended. Start date (EU): 2026-01-22. End date (EU): 2026-03-04. Decision date: 2025-12-10. Results received: No. Last updated: 2025-12-19.

Condition(s): Healthy volunteer trial

Source: https://euclinicaltrials.eu/ctis-public/view/2025-522311-41-00